EU clinical trial 2023-509571-16-00: Study of RMC-6291, With or Without RMC-6236, in Combination With Other Anti-Cancer Agents, in Patients With RAS G12C-Mutated Non-Small Cell Lung Cancer – Subprotocol A
Protocol code: RMC-LUNG-101A
Sponsor: Revolution Medicines Inc. (Pharmaceutical company). Phase: Human Pharmacology (Phase I)- Other. Countries: Spain (ongoing, recruiting), Italy (ongoing, recruiting), Germany (ongoing, recruiting), Netherlands (ongoing, recruiting), France (ongoing, recruiting).
Therapeutic area(s): Diseases [C] - Respiratory Tract Diseases [C08]
Gender: Female, Male. Age: 18-64 years, 65+ years. Enrolment: 162.
Status: Ongoing, recruiting. Start date (EU): 2024-07-17. Decision date: 2024-06-17. Results received: No. Last updated: 2026-06-15.
Decision dates by country: DE: 2024-06-19, NL: 2024-09-23, ES: 2024-06-17, IT: 2024-06-20, FR: 2024-09-23

Condition(s): Lung Cancer
Product: CISPLATIN, Cisplatinum Accord, 1 mg/ml, koncentrat do sporządzania roztworu do infuzji., Cisplatinum Accord, 1 mg/ml, koncentrat do sporządzania roztworu do infuzji., RMC-6291, Cisplatinum Accord, 1 mg/ml, koncentrat do sporządzania roztworu do infuzji., DARAXONRASIB (RMC-6236), DARAXONRASIB (RMC-6236), Cisplatinum Accord, 1 mg/ml, koncentrat do sporządzania roztworu do infuzji., RMC-6291, PEMBROLIZUMAB, CARBOPLATIN, PEMETREXED

Primary endpoint: • Incidence of DLTs (Part 1 and Part 2 Cohort A2, A3 and A4 safety lead-in only) •Incidence of TEAEs, TRAEs, SAEs, and clinically significant changes in laboratory test values, ECGs, and vital signs
Endpoint(s): RMC-6291 plasma concentrations overtime and PK parameters as applicable. RMC-6291 plasma and RMC-6236 blood concentration over time and PK parameters as applicable • ORR and DOR per RECIST v1.1

Source: https://euclinicaltrials.eu/ctis-public/view/2023-509571-16-00